EU clinical trial 2023-504518-31-01: Leveraging the neural mechanisms of social reward for drug relapse prevention
Sponsor: Fondazione Santa Lucia IRCCS (Hospital/Clinic/Other health care facility). Phase: Therapeutic exploratory (Phase II). Countries: Italy (authorised, recruitment pending).
Therapeutic area(s): Psychiatry and Psychology [F] - Mental Disorders [F03]
Gender: Female, Male. Age: 18-64 years. Enrolment: 70.
Status: Authorised, recruitment pending. Decision date: 2026-05-29. Results received: No. Last updated: 2026-05-29.

Condition(s): substance use disorder
Product: Syntocinon 40 IE/ml neusspray, oplossing, Ialu Clenny nasal spray (hyaluronic acid and isotonic saline solution), CE-marked medical device. Used as placebo comparator in this clinical trial. The product does not contain the active investigational medicinal product (oxytocin). Although commercially marketed as a medical device, when used as placebo within this clinical trial it is handled in accordance with Annex 13 GMP requirements for IMPs, including appropriate labelling and QP certification.

Primary endpoint: - Cue-incubation of craving - BOLD fMRI activation signal in the amygdala, insula, ventral striatum and anterior cingulate cortex Timepoint(s) of evaluation of this endpoint Self-report measure of craving following cue exposures at day 7 and day 30 (one week and four weeks into the placebo/Syntocinon treatment period) compared to day 1. BOLD fMRI signal will be evaluated on day 30 compared to day 1.
Endpoint(s): - Measures of social/emotional cognition evaluated via Picture viewing task, Go/no-go task, Cyberball task and Social Gaze task - Duration of abstinence Timepoint(s) of evaluation of this endpoint Scores will be registered at day 7 and day 30 (one week and four weeks into the placebo/Syntocinon treatment period) compared to day 1. To assess duration of abstinence, drug use will be evaluated at follow ups at 3- and 6-months following termination of treatment period.

Source: https://euclinicaltrials.eu/ctis-public/view/2023-504518-31-01